EU clinical trial 2024-515448-22-00: A Phase 2, Randomized, Double-Blind, Placebo-Controlled Study and Open-Label Extension to Evaluate the Safety and Efficacy of NEU-411 in Companion Diagnostic-Positive Participants with Early Parkinson’s Disease (NEULARK)
Protocol code: NEU-411-PD201
Sponsor: Neuron23 Inc. (Pharmaceutical company). Phase: Therapeutic exploratory (Phase II). Countries: Spain (authorised, recruitment pending), Poland (authorised, recruitment pending), Italy (authorised, recruitment pending).
Therapeutic area(s): Diseases [C] - Nervous System Diseases [C10]
Gender: Female, Male. Age: 18-64 years, 65+ years. Enrolment: 60.
Status: Authorised, recruitment pending. Decision date: 2025-05-19. Results received: No. Last updated: 2026-08-07.
Decision dates by country: ES: 2025-05-19, PL: 2025-05-19, IT: 2025-05-19

Condition(s): Parkinson Disease, Idiopathic, Early Parkinson Disease, Parkinson's disease, Idiopathic Parkinson Disease, Parkinson
Product: NEU-411, Placebo NEU-411 maleate

Primary endpoint: Change from baseline in the Roche digital biomarker score using the Roche Parkinson's Disease application (v3.0) compared to placebo Time Frame: From enrollment to the end of treatment at 52 weeks, Incidence of treatment-emergent adverse events (TEAEs) and serious adverse events (SAEs) compared to placebo Time Frame: From enrollment to the end of study at 54 weeks
Endpoint(s): Change from baseline to Week 52 in motor function/nonmotor as measured by Movement Disorder Society’s Unified Parkinson’s Disease Rating Scale (MDS-UPDRS)

Source: https://euclinicaltrials.eu/ctis-public/view/2024-515448-22-00